EU clinical trial 2025-520623-24-00: (22931) A first-in-human study to evaluate the safety, tolerability and pharmacokinetics, pharmacodynamics and preliminary clinical activity of BAY 3713372, a novel 2nd generation PRMT5 inhibitor, in participants with MTAP-deleted solid tumors.
Protocol code: 22931
Sponsor: Bayer AG (Pharmaceutical company). Phase: Phase I and Phase II (Integrated)- First administration to humans. Countries: Belgium (ongoing, recruiting), Sweden (ongoing, recruiting), Denmark (ongoing, recruiting), Italy (ongoing, recruiting), Spain (ongoing, recruiting), Netherlands (ongoing, recruiting), Czechia (ongoing, recruiting).
Therapeutic area(s): Diseases [C] - Neoplasms [C04]
Gender: Female, Male. Age: 18-64 years, 65+ years. Enrolment: 195.
Status: Ongoing, recruiting. Start date (EU): 2025-11-19. Decision date: 2025-11-04. Results received: No. Last updated: 2026-07-24.
Decision dates by country: SE: 2025-11-07, IT: 2025-11-10, CZ: 2025-11-04, NL: 2025-11-06, BE: 2025-11-04, ES: 2025-11-05, DK: 2025-11-04

Condition(s): MTAP-deleted Solid Tumors
Product: BAY 3713372 Bayer, BAY 3713372 Bayer

Primary endpoint: Dose Escalation (Master and Intervention Cohort 1): Number of participants with treatment-emergent adverse events (TEAEs)., Dose Escalation (Master and Intervention Cohort 1): Number of participants with treatment-emergent serious adverse events (TESAEs)., Dose Escalation (Master and Intervention Cohort 1): Severity of treatment-emergent adverse events (TEAEs) and treatment-emergent serious adverse events (TESAEs)., Dose Escalation (Master and Intervention Cohort 1): Incidence of dose-limiting toxicities (DLTs)., Dose Escalation (Master and Intervention Cohort 1): Number of participants with DLTs from the first dose of study intervention to the end of Cycle 1 (each cycle is 21 days)., Dose Escalation (Master and Intervention Cohort 1): Maximum concentration (Cmax) of the respective dosing interval of BAY 3713372 after single dose and multiple dose administrations., Dose Escalation (Master and Intervention Cohort 1): Area under the curve (AUC) of the respective dosing interval of BAY 3713372 after single dose and multiple dose administrations., Dose Expansion (Master, Intervention Cohorts 1 – 6): Objective response rate (ORR) as determined by the Investigator according to Response Evaluation Criteria in Solid Tumors, Version 1.1 (RECIST v1.1)., Dose Expansion (Intervention Cohorts 3, 4 and 6): Number of participants with DLTs from the first dose of study intervention to the end of Cycle 1 (each cycle is 21 days).
Endpoint(s): Dose Escalation (Master and Intervention Cohort 1): Objective response rate (ORR) as determined by the Investigator according to Response Evaluation Criteria in Solid Tumors, Version 1.1 (RECIST v1.1)., Dose Escalation (Master and Intervention Cohort 1): Duration of response (DOR) as determined by the Investigator according to RECIST v1.1., Dose Escalation (Master and Intervention Cohort 1): Progression-free survival (PFS) as determined by the Investigator according to RECIST v1.1., Dose Escalation (Master and Intervention Cohort 1): Time to response (TTR)., Dose Expansion (Master, Intervention Cohorts 1 – 6): Number of participants with treatment-emergent adverse events (TEAEs)., Dose Expansion (Master, Intervention Cohorts 1 – 6): Number of participants with treatment-emergent serious adverse events (TESAEs)., Dose Expansion (Master, Intervention Cohorts 1 – 6): Severity of treatment-emergent adverse events (TEAEs) and treatment-emergent serious adverse events (TESAEs)., Dose Expansion (Master, Intervention Cohorts 1, 3, 4, and 6): Incidence of dose-limiting toxicities (DLTs)., Dose Expansion (Master, Intervention Cohorts 1 – 6): Duration of response (DOR) as determined by the Investigator according to RECIST v1.1., Dose Expansion (Master, Intervention Cohorts 1 – 6): Progression-free survival (PFS) as determined by the Investigator according to RECIST v1.1., Dose Expansion (Master, Intervention Cohorts 1 – 6): Time to response (TTR)., Dose Expansion (Master, Intervention Cohorts 1 – 4, and 6): Maximum concentration (Cmax) of the respective dosing interval of BAY 3713372 after single dose and multiple dose administrations., Dose Expansion (Master, Intervention Cohorts 1 – 4, and 6): Area under the curve (AUC) of the respective dosing interval of BAY 3713372 after single dose and multiple dose administrations., Dose Expansion (Part A of Intenvention Cohort 2): Time to CNS progression (CNS-TTP), Dose Expansion (Part B of Intervention Cohort 2): CNS-ORR for active brain metastases, Dose Expansion (Part B of Intervention Cohort 2): CNS-DOR for active brain metastases, Dose Expansion (Part B of Intervention Cohort 2): CNS-PFS for active brain metastases, Dose Expansion (Part B of Intervention Cohort 2): CNS-TTR for active brain metastases, Dose Expansion (Part B of Intervention Cohort 2): CNS-related disease control rate (CNS-DCR) in active brain metastases

Source: https://euclinicaltrials.eu/ctis-public/view/2025-520623-24-00